EU clinical trial 2024-513810-36-00: Ergogenic effects of pseudoephedrine on edurance performance in relation to the determination of threshold values in urine and capillary and venous blood
Protocol code: ONZ-2023-0546
Sponsor: Universiteit Gent (Educational Institution). Phase: Therapeutic use (Phase IV). Countries: Belgium (ongoing, recruiting).
Therapeutic area(s): Not possible to specify
Gender: Female, Male. Age: 18-64 years. Enrolment: 30.
Status: Ongoing, recruiting. Start date (EU): 2025-08-27. Decision date: 2025-05-08. Results received: No. Last updated: 2026-04-14.
Decision dates by country: BE: 2025-07-15

Condition(s): Healthy volunteers
Product: Vasocedine pseudoephedrine 60 mg, filmomhulde tabletten, P-Tabletten weiß 7 mm Lichtenstein

Primary endpoint: Change in time trial duration (and average power output) when the placebo trial (0 mg) is compared to the trial with ingestion of 240 mg Pseudoephedrine
Endpoint(s): Changes in physiological parameters (cardiovascular, oxidative and metabolic) during the 90’ long cycling race simulation when the placebo trial (0 mg) is compared to the trial with ingestion of 120 mg Pseudoephedrine, Changes in physiological parameters (cardiovascular, oxidative and metabolic) during the 90’ long cycling race simulation when the placebo trial (0 mg) is compared to the trial with ingestion of 240 mg Pseudoephedrine, The upper limit of the 95% CI of the mean maximal measured blood/urine pseudoephedrine concentration after ingestion of 240 mg of pseudoephedrine for each sampling method (TASSO+, VAMS, DBS, Venapuncture and urine collection), Change in time trial duration (and average power output) when the half-dose trial (120 mg) is compared to the trial with ingestion of 0 mg Pseudoephedrine., Change in time trial duration (and average power output) when the half-dose trial (120 mg) is compared to the trial with ingestion of 240 mg Pseudoephedrine.

Source: https://euclinicaltrials.eu/ctis-public/view/2024-513810-36-00